EU clinical trial 2024-516794-70-00: A Phase 2, Randomized, Blinded, Placebo-Controlled Trial Investigating the Efficacy and Safety of Visugromab plus Nivolumab with or without Docetaxel versus Docetaxel Monotherapy in Second-Line Treatment of Participants with Metastatic Non-Squamous Non-Small Cell Lung Cancer (GDFATHER-NSCLC-02)
Protocol code: CTL-002-004
Sponsor: CatalYm GmbH (Pharmaceutical company). Phase: Therapeutic exploratory (Phase II). Countries: Spain (ongoing, recruiting), Italy (ongoing, recruiting), Germany (ongoing, recruiting), Poland (authorised, recruiting), Romania (ongoing, recruiting).
Therapeutic area(s): Diseases [C] - Neoplasms [C04]
Gender: Female, Male. Age: 18-64 years, 65+ years. Enrolment: 103.
Start date (EU): 2025-11-03. Decision date: 2025-10-06. Results received: No. Last updated: 2026-07-29.
Decision dates by country: RO: 2025-10-08, PL: 2025-10-07, IT: 2025-10-07, DE: 2025-10-08, ES: 2025-10-06

Condition(s): Metastatic non-squamous non-small cell lung cancer
Product: NIVOLUMAB, SODIUM CHLORIDE, DOCETAXEL, Visugromab (CTL-002)

Primary endpoint: Objective response rate (ORR), defined as the percentage of participants with a best overall response (BOR) of complete response (CR) or partial response (PR) per Response Evaluation Criteria in Solid Tumors (RECIST) v1.1 as assessed by the Investigator at any time during the Core Trial Period.
Endpoint(s): 1. Incidence, type and severity of adverse events (AEs), recorded as treatment emergent adverse events (TEAEs), treatment related AEs (including immune mediated Adverse Events (imAEs) as AEs of Special Interest (AESIs)) and serious adverse events (SAEs)., 2. Complete response (CR) rate., 3. Partial response (PR) rate., 4. Objective response rate (ORR)., 5. Duration of response (DOR)., 6. Time to response (TTR)., 7. Progression free survival (PFS)., 8. Overall survival (OS)., 9. Participant weight course over time., 10. Maximum concentration (Cmax)., 11. Minimum concentration (Cmin)., 12. Participants’ subjective well-being as assessed via the Non-Small Cell Lung Cancer-Symptom Assessment Questionnaire (NSCLC-SAQ).

Source: https://euclinicaltrials.eu/ctis-public/view/2024-516794-70-00